EU clinical trial 2023-507613-10-01: A Phase 1/2 Open-Label Study to Evaluate the Safety and Efficacy of Autologous CD19-specific Chimeric Antigen Receptor T cells (CABA-201) in Subjects with Active Systemic Lupus Erythematosus
Protocol code: CAB-201-001
Sponsor: Cabaletta Bio Inc. (Pharmaceutical company). Phase: Phase I and Phase II (Integrated)- First administration to humans. Countries: Spain (ongoing, recruiting), France (authorised, recruiting).
Therapeutic area(s): Diseases [C] - Immune System Diseases [C20]
Gender: Female, Male. Age: 0-17 years, 18-64 years, 65+ years. Enrolment: 6.
Start date (EU): 2025-03-31. Decision date: 2024-09-18. Results received: No. Last updated: 2026-08-03.
Decision dates by country: FR: 2024-10-21, ES: 2024-09-18

Condition(s): Active Systemic Lupus Erythematosus;Systemic lupus erythematosus (SLE) is a chronic autoimmune disorder characterized by autoantibody production and abnormal B cell function. SLE presents with fluctuating severity and may cause tissue damage in a variety of organs over time. Lupus nephritis (LN) is a common severe manifestation of SLE, which can lead to significant morbidity and mortality.
Product: CYCLOPHOSPHAMIDE SANDOZ 1000 mg, poudre pour solution injectable ou pour perfusion, FLUDARABINE ACCORD 25 mg/ml, solution à diluer pour solution injectable/pour perfusion, Fludarabina Teva 25 mg/ml concentrado para solución para perfusión o inyección EFG, Genoxal 1.000 mg polvo para solución inyectable y para perfusión

Primary endpoint: AEs occurring within 28 days after CABA-201 infusion, including DLTs and AEs related to CABA-201.
Endpoint(s): AEs, vital signs, physical examination, and clinical laboratory tests occurring within 156 weeks after CABA-201 infusion., Changes from baselinea in WBC with differential, including B cell counts., Frequency of reaching released product at target dose., Fold cell expansion, transduction efficiency, vector copy number per cell, and product phenotype; Total number of CABA-201-positive cells in each manufacturing run; Percent of CAR-transduced cells in the total number of cells for infusion., Number and percentage of CABA-201-positive cells in the peripheral blood of subjects over time., Changes from baseline in anti-dsDNA antibodies, C3, C4, and CH50., Changes in UPCR, eGFR, SLEDAI-2K score, BILAG-2004 score, PGA score, joint counts, CLASI score, and SDI.; Proportions of subjects achieving complete renal response (for LN cohort only), SRI-4, BICLA responses, and LLDAS and DORIS criteria., Time to achieve complete renal response (for LN cohort only), SRI-4, SRI-5, SRI-6, BICLA responses, LLDAS, and DORIS /Additional endpoint for adolescents: time to achieve modified PRINTO/ACR juvenile response criteria, Change from baseline in the dose of concomitant corticosteroids and other SLE-related therapies.; Proportion of subjects achieving a dose of ≤5 mg/day oral prednisone or equivalent.; Proportion of subjects who require no SLE-related therapies., Adults:Changes from baselinea in SF-36v2, pain NRS, FACIT-F, PtGA, Lupus QoL, and EQ-5D-5L scores. Adolescents: Changes from baselinea in pain NRS, PtGA, PedsQL, and PedsQL multidimensional Fatigue Scale, Incidences of mild/moderate and severe disease flare per BILAG-2004 and SFI.; Time to mild/moderate and severe disease flare., Proportions of subjects achieving drug free complete renal response (for LN cohort only), SRI-4, BICLA responses and LLDAS, and DORIS/ Additional endpoint for adolescents: proportion of subjects achieving drug-free complete modified PINTO/ACR juvenile response criteria, Time to achievement of drug-free complete renal response (for LN cohort only), SRI-4, BICLA responses, LLDAS and DORIS. Additional endpoint for adolescents: time to achievement of drug-free modified PINTO/ACR juvenile response criteria

Source: https://euclinicaltrials.eu/ctis-public/view/2023-507613-10-01